EU clinical trial 2023-505095-29-03: Iron Infusion in Elderly Patients undergoing Transcatheter Aortic Valve Implantation (IRON TAVI) Trial
Sponsor: Erasmus Universitair Medisch Centrum Rotterdam (Erasmus MC) (Hospital/Clinic/Other health care facility). Phase: Therapeutic use (Phase IV). Countries: Netherlands (authorised, recruitment pending).
Therapeutic area(s): Diseases [C] - Pathological Conditions, Signs and Symptoms [C23]
Gender: Female, Male. Age: 18-64 years, 65+ years. Enrolment: 378.
Status: Authorised, recruitment pending. Decision date: 2023-12-07. Results received: No. Last updated: 2024-02-19.

Condition(s): Patients with Aortic stenosis and Iron deficiency
Product: Ferinject

Primary endpoint: Quality of life at 6 months (using the 23-item Kansas City Cardiomyopathy Questionnaire, KCCQ-23, as continuous variable), Exercise capacity at 6 months (using 6-minute walk test, 6-MWT as continuous variable).
Endpoint(s): Cognitive function at 6 months (using the Mini Mental State Examination, MMSE as continuous variable)., NYHA classification at 6 months (as continuous variable)., Patient Global Assessment at 6 months (as continuous variable)., European Quality of Life-5 Dimensions Utility Index (EQ-5D-UI) and Visual Analog Scale (EQ-5D-VAS) at 6 months (as continuous variable)., Composite of cardiovascular mortality and heart failure hospitalizations at 6 months, All-cause mortality at 6 months, Favourable quality of life (survival with KCCQ-score ≥60 without KCCQ-decline >10 points from baseline to follow-up) at 6 months

Source: https://euclinicaltrials.eu/ctis-public/view/2023-505095-29-03